EU clinical trial 2024-517575-20-00: Clinical safety study on 5-Aminolevulinic acid (5-ALA) in children and adolescents with brain tumors (5-ALA in children and adolescents)
Protocol code: UKM2013_0034
Sponsor: Universitaet Muenster (Educational Institution). Phase: Therapeutic exploratory (Phase II). Countries: Germany (ended), Netherlands (ended).
Therapeutic area(s): Diseases [C] - Neoplasms [C04]
Gender: Female, Male. Age: 0-17 years. Enrolment: 51.
Status: Ended. Start date (EU): 2020-08-24. End date (EU): 2025-11-24. Decision date: 2024-11-06. Results received: No. Last updated: 2025-02-28.
Decision dates by country: DE: 2024-11-14, NL: 2024-11-06

Condition(s): different types of brain tumors
Product: Gliolan 30 mg/ml powder for oral solution., Gliolan 30 mg/ml powder for oral solution., Gliolan 30 mg/ml powder for oral solution.

Primary endpoint: Primary endpoint is the incidence of adverse events of CTCAE Version 4.0 grades III, IV or V (excluding chemotherapy-associated toxicities) during and after 5-ALA fluorescence-guided resections in children and adolescents with unifocal, , contrast-enhancing intra-axial brain tumors.
Endpoint(s): The true positive rate of 5-ALA-induced fluorescence for predicting bulk tumor tissue, or tumor at the border area or infiltrating tumor will be determined from histopathology of fluorescing tissue biopsies. Only tissue, which is destined for removal under white light conditions due to its appearance and resectability, is to be assessed. The location of residual tissue which is left unresected and which shows fluorescence will be documented by the neurosurgeon., For the determination of the degree of resection, for every patient in whom a complete resection of enhancing tumor is expected a priori, it will be assessed whether there is residual contrast-enhancement visible on early post-operative MRI. The relationship between residual fluorescence and possible residual enhancing tumor will be described qualitatively., If possible and if consent is given, blood samples will be collected 3 times within 12h after administration of 5-ALA for determination of PPIX in plasma to elucidate 5-ALA metabolism in children and adolescents.

Source: https://euclinicaltrials.eu/ctis-public/view/2024-517575-20-00